EU clinical trial 2025-524843-11-00: A Master Protocol of an Open-Label, Multi-Drug, Multi-Centre, Phase II Study to Evaluate the Safety, Tolerability, Pharmacokinetics, Immunogenicity, and Antitumour Activity of Novel Combinations in Participants with Locally Advanced or Metastatic Non-Small Cell Lung Cancer (LIBRA)
Protocol code: D6187C00001
Sponsor: AstraZeneca AB (Pharmaceutical company). Phase: Therapeutic exploratory (Phase II). Countries: France (authorised, recruiting), Italy (authorised, recruiting), Spain (ongoing, recruiting).
Therapeutic area(s): Diseases [C] - Neoplasms [C04]
Gender: Female, Male. Age: 18-64 years, 65+ years. Enrolment: 70.
Start date (EU): 2026-06-15. Decision date: 2026-05-06. Results received: No. Last updated: 2026-05-18.
Decision dates by country: FR: 2026-05-07, IT: 2026-05-06, ES: 2026-05-18

Condition(s): Non-Small Cell Lung Cancer
Product: MYCOPHENOLATE MOFETIL, Rilvegostomig, RAMUCIRUMAB, INFLIXIMAB

Primary endpoint: Number of participants with adverse events (AE) and serious adverse events (SAE), Objective response rate (ORR)
Endpoint(s): Best Overall Response(BOR), Change in Target Lesion Tumor Size, Progression free survival (PFS), Disease Control Rate(DCR) at 12 Weeks, Duration Of Response (DoR), Overall Survival(OS), Serum concentration, Maximum plasma drug concentration (Cmax), Immunogenicity of study interventions in participants receiving treatment

Source: https://euclinicaltrials.eu/ctis-public/view/2025-524843-11-00